EU clinical trial 2023-505336-34-00: Open-label Rollover Study to Evaluate Long-Term Safety in Subjects with Metastatic Solid Tumors that are Benefiting from Continuation of Therapy with Sacituzumab Govitecan
Protocol code: IMMU-132-14
Sponsor: Gilead Sciences Inc. (Pharmaceutical company). Phase: Therapeutic use (Phase IV). Countries: Spain (ended), Belgium (ended), France (ended).
Therapeutic area(s): Diseases [C] - Neoplasms [C04]
Gender: Female, Male. Age: 18-64 years, 65+ years. Enrolment: 5.
Status: Ended. Start date (EU): 2020-10-08. End date (EU): 2024-10-17. End date: 2024-10-18. Decision date: 2023-10-02. Results received: Yes. Last updated: 2024-10-01.
Decision dates by country: BE: 2023-10-04, FR: 2023-10-02, ES: 2023-10-02

Condition(s): Metastatic solid tumors
Product: Trodelvy 200 mg powder for concentrate for solution for infusion

Primary endpoint: The primary endpoints are as follows: Percentage of participants experiencing any AE., Percentage of participants experiencing any SAE., Percentage of participants experiencing any laboratory abnormality.

Source: https://euclinicaltrials.eu/ctis-public/view/2023-505336-34-00